EU clinical trial 2022-502102-32-00: A Phase III, Multicenter, Randomized, Double-Blind, Placebo-Controlled Study to Evaluate the Efficacy and Safety of Sefaxersen, an Antisense Inhibitor of Complement Factor B, in Patients with Primary IgA Nephropathy at High Risk of Progression
Protocol code: WA43966
Sponsor: F. Hoffmann-La Roche AG (Pharmaceutical company). Phase: Therapeutic confirmatory (Phase III). Countries: France (ongoing, recruitment ended), Greece (ongoing, recruitment ended), Czechia (ongoing, recruitment ended), Germany (ongoing, recruitment ended), Italy (ongoing, recruitment ended), Spain (ongoing, recruitment ended), Poland (ongoing, recruitment ended).
Therapeutic area(s): Diseases [C] - Female Urogenital Diseases and Pregnancy Complications [C13]; Diseases [C] - Male Urogenital Diseases [C12]
Gender: Female, Male. Age: 18-64 years, 65+ years. Enrolment: 87.
Status: Ongoing, recruitment ended. Start date (EU): 2023-11-16. Decision date: 2023-10-17. Results received: No. Last updated: 2026-06-23.
Decision dates by country: FR: 2023-10-18, DE: 2023-10-17, ES: 2023-10-18, CZ: 2023-10-19, GR: 2023-10-19, IT: 2023-10-18, PL: 2023-10-23

Condition(s): Primary Immunoglobulin A (IgA) Nephropathy
Product: ASO FACTOR B, PNEUMOCOCCUS, PURIFIED POLYSACCHARIDES ANTIGEN, ASO FACTOR B PLACEBO

Primary endpoint: Change in proteinuria, as measured by the UPCR change at Week 37 from baseline from a 24-hour collection
Endpoint(s): Change in eGFR at Week 105 from baseline. eGFR will be calculated using the 2021 Chronic Kidney Disease Epidemiology Collaboration (CKD-EPI) creatinine equation, Time to the composite kidney failure endpoint, defined as receipt of kidney transplantation, need for kidney replacement therapy, a sustained decline in eGFR of ≥ 30% from baseline, or a sustained eGFR < 15 mL/min/1.73m2 over at least 4 weeks (both eGFR criteria requiretwo consecutive central laboratory eGFR values meeting criteria ≥ 4 weeks apart), whichever occurs first, without the receipt of other immunosuppressive or background therapies for the treatment of IgAN, Change in fatigue at Week 105 compared with baseline, as assessed through the use of the Functional Assessment of Chronic Illness Therapy−Fatigue Scale, Incidence and severity of treatment-emergent adverse events, with severity determined according to the National Cancer Institute Common Terminology Criteria for Adverse Events, Version 5.0 grading scale, Plasma concentrations of Sefaxersen conjugated and/or unconjugated equivalent at specified timepoints

Source: https://euclinicaltrials.eu/ctis-public/view/2022-502102-32-00